EU clinical trial 2024-517119-59-00: Neoadjuvant treatment in rectal cancer with radiotherapy followed by atezolizumab and bevacizumab - TARZAN
Protocol code: N18TRZ
Sponsor: Het Nederlands Kanker Instituut-Antoni van Leeuwenhoek Ziekenhuis Stichting (Hospital/Clinic/Other health care facility). Phase: Therapeutic exploratory (Phase II). Countries: Netherlands (ongoing, recruiting).
Therapeutic area(s): Diseases [C] - Neoplasms [C04]; Diseases [C] - Digestive System Diseases [C06]
Gender: Female, Male. Age: 18-64 years, 65+ years. Enrolment: 38.
Status: Ongoing, recruiting. Start date (EU): 2019-09-26. Decision date: 2024-10-28. Results received: No. Last updated: 2024-10-28.

Condition(s): Rectal cancer
Product: Tecentriq 1 200 mg concentrate for solution for infusion, Avastin 25 mg/ml concentrate for solution for infusion.

Primary endpoint: The primary endpoint is clinical complete and near-complete response rate (c(n)CR) assessed at week 12 post-radiotherapy
Endpoint(s): Safety: incidence and severity of AEs (with severity determined according to NCI CTCAE v5.0), vital signs and clinical laboratory test results., Pre-operative treatment-related complications leading to delays in systemic treatment and/or surgery (excluding non-treatment-related and logistical reasons). Delays in surgery are defined as treatment-related delays beyond 4-6 weeks after the clinical decision has been made to operate, Relapse-free survival (RFS), defined as the time from study enrolment to disease recurrence or disease-related death during follow-up, Local recurrence rate (LRR) at 1 year follow-up, Proportion of patients who undergo organ preserving treatment defined as the patients who at evaluation at T12w are found to have a (near-) complete response and thus planned for watchful waiting or local excision., Pathological complete and near-complete response (pCR), defined as Mandard TRG 1-2, if available, Radiological tumor regression using MRI (ESGAR consensus guidelines)

Source: https://euclinicaltrials.eu/ctis-public/view/2024-517119-59-00